EU clinical trial 2022-500883-37-00: Safety and efficacy of GSK Neisseria gonorrhoeae GMMA (NgG) investigational vaccine when administered to healthy adults 18 to 50 years of age
Protocol code: 216156 (NGG-001)
Sponsor: Glaxosmithkline Biologicals (Pharmaceutical company). Phase: Phase I and Phase II (Integrated)- First administration to humans. Countries: Germany (ended), Spain (ended), France (ended).
Therapeutic area(s): Diseases [C] - Bacterial Infections and Mycoses [C01]
Gender: Female, Male. Age: 18-64 years. Enrolment: 592.
Status: Ended. Start date (EU): 2023-10-02. End date (EU): 2025-05-21. End date: 2025-05-22. Decision date: 2023-05-03. Results received: No. Last updated: 2025-04-30.
Decision dates by country: ES: 2023-05-05, DE: 2023-05-05, FR: 2025-04-23

Condition(s): This FTiH-PoC study aims to provide an early evaluation of the efficacy of the investigational vaccine as there are no established immunogenicity correlates of protection against infections caused by Neisseria gonorrhoeae.

Source: https://euclinicaltrials.eu/ctis-public/view/2022-500883-37-00